EU clinical trial 2025-523534-11-00: Evaluation of the effect of intravenous lidocaine on the systemic inflammatory response associated with cardiopulmonary bypass in patients undergoing elective valvular and coronary cardiac surgery: A randomized double-blind clinical trial.
Sponsor: Hospital San Pedro (Hospital/Clinic/Other health care facility). Phase: Therapeutic exploratory (Phase II). Countries: Spain (ongoing, recruiting).
Therapeutic area(s): Diseases [C] - Cardiovascular Diseases [C14]; Analytical, Diagnostic and Therapeutic Techniques and Equipment [E] - Anesthesia and Analgesia [E03]
Gender: Female, Male. Age: 18-64 years, 65+ years. Enrolment: 90.
Status: Ongoing, recruiting. Start date (EU): 2025-12-15. Decision date: 2025-11-19. Results received: No. Last updated: 2025-11-19.

Condition(s): Patients undergoing elective cardiac valve surgery and/or coronary artery bypass grafting with cardiopulmonary bypass, at risk of systemic inflammatory response and related postoperative complications.
Product: Lidocaína B. Braun 20 mg/ml solución inyectable, Salina Fisiológica Grifols 0,9% solución para perfusión

Primary endpoint: Levels of Interleukin-6 (IL-6) in arterial blood at 6 hours postoperatively, measured by electrochemiluminescence immunoassay (ECLIA) using the laboratory’s validated platform according to its protocols.
Endpoint(s): Levels of C-reactive protein (CRP), high-sensitivity Troponin T (TnT), and TNF-α in arterial blood at predefined time points: pre-anaesthesia, at the start of cardiopulmonary bypass, end of surgery, and 6 and 24 hours postoperatively. CRP will be measured by immunoturbidimetric assay, and TnT and TNF-α by electrochemiluminescence immunoassay (ECLIA) using the laboratory’s validated platforms and standard protocols., Postoperative complications associated with systemic inflammatory response: Includes: Acute Kidney Injury, Infection/Sepsis, Multiple Organ Dysfunction, Haemorrhage requiring transfusion, Vasoplegia, Respiratory Dysfunction, and Neurological Dysfunction. Detailed definitions are provided in the study protocol., ICU Length of Stay: Total duration of the patient’s admission in the Intensive Care Unit, expressed in days, from admission to ICU discharge., One-Month Postoperative Mortality: Denotes whether the patient succumbed to any cause within the first 30 days following the date of surgery., Post-Aortic Declamping Ventricular Fibrillation and Need for Defibrillation: Indicates the occurrence of ventricular fibrillation at the moment of aortic declamping and whether this arrhythmia required electrical defibrillation to restore sinus rhythm., Postoperative Pain: Assessed using two indicators: Number of analgesic rescues: Total additional doses of analgesics required beyond the scheduled regimen during the first 48 postoperative hours. Total opioid dose administered: Cumulative opioid dose in the first 48 hours postoperatively, expressed in milligrams of intravenous morphine equivalents.

Source: https://euclinicaltrials.eu/ctis-public/view/2025-523534-11-00